EU clinical trial 2024-519060-40-00: A study of safety, feasibility and immunologic response of transfering tumor infiltrating lymphocytes with or without dendritic cell vaccination in patients with metastatic melanoma
Protocol code: MAT02
Sponsor: Karolinska University Hospital (Hospital/Clinic/Other health care facility). Phase: Human Pharmacology (Phase I)- Other. Countries: Sweden (authorised, recruitment pending).
Therapeutic area(s): Diseases [C] - Neoplasms [C04]
Gender: Female, Male. Age: 18-64 years, 65+ years. Enrolment: 20.
Status: Authorised, recruitment pending. Decision date: 2025-01-23. Results received: No. Last updated: 2025-01-23.

Condition(s): Advanced metastatic malignant melanoma stage 3 or 4 with measurable lesions in internal organs.

Source: https://euclinicaltrials.eu/ctis-public/view/2024-519060-40-00